EU clinical trial 2024-515756-20-00: A randomized controlled trial of Rikkunshito (TJ-43) in Functional Dyspepsia patients recruited from primary care.
Sponsor: UZ Leuven (Hospital/Clinic/Other health care facility). Phase: Therapeutic confirmatory (Phase III). Countries: Belgium (ongoing, recruiting).
Therapeutic area(s): Diseases [C] - Digestive System Diseases [C06]; Diseases [C] - Pathological Conditions, Signs and Symptoms [C23]
Gender: Female, Male. Age: 18-64 years, 65+ years. Enrolment: 100.
Status: Ongoing, recruiting. Start date (EU): 2025-01-30. Decision date: 2024-12-18. Results received: No. Last updated: 2026-06-05.

Condition(s): Functional Dyspepsia
Product: Matching placebo granules, Rikkunshito

Primary endpoint: The primary endpoint of this study is to evaluate the therapeutic effect of Rikkunshito on functional dyspepsia symptoms. This will be assessed by the previously validated Leuven Postprandial Distress Scale (LPDS) diary. The percentage of response after treatment with Rikkunshito compared to placebo. The response rate is assessed with the LPDS daily diary (19). A responder is defined by the clinically relevant difference of 0.7 for the LPDS score (average of 3 PDS questions).
Endpoint(s): The effect of Rikkunshito versus placebo on duodenal mucosal parameters before and after treatment., The effect of Rikkunshito versus placebo on individual PDS and EPS clinical symptoms, assessed with the LPDS daily diary symptom questionnaire during the 8 weeks therapy., The effect of Rikkunshito versus placebo on clinical symptoms, assessed with the LPDS daily diary with a minimum clinically important difference of 0.5 for the PDS symptoms (average of 3 questions) by comparing pretreatment baseline scores with the average score during the last 2 weeks on treatment (responder definition)., The effect of Rikkunshito versus placebo on quality of life, depression, anxiety and somatization co-morbidity, evaluated by the PAGI-Qol and PHQ questionnaires, The effect of Rikkunshito versus placebo on upper gastrointestinal symptoms, evaluated by the PAGI-SYM questionnaire.

Source: https://euclinicaltrials.eu/ctis-public/view/2024-515756-20-00